EU clinical trial 2023-509662-38-00: Efficacy and safety of co-administered cagrilintide and semaglutide (CagriSema) once weekly versus placebo in participants with type 2 diabetes and painful diabetic peripheral neuropathy
Protocol code: NN9388-7864
Sponsor: Novo Nordisk A/S (Pharmaceutical company). Phase: Therapeutic exploratory (Phase II). Countries: Norway (ended), Denmark (ended), Spain (ongoing, recruitment ended), France (ended).
Therapeutic area(s): Diseases [C] - Nutritional and Metabolic Diseases [C18]
Gender: Female, Male. Age: 18-64 years, 65+ years. Enrolment: 53.
Start date (EU): 2025-01-22. Decision date: 2024-12-09. Results received: No. Last updated: 2026-07-16.
Decision dates by country: NO: 2024-12-09, ES: 2024-12-11, DK: 2024-12-10, FR: 2024-12-09

Condition(s): Type 2 diabetes and painful diabetic peripheral neuropathy
Product: cagrilintide semaglutide, cagrilintide semaglutide, cagrilintide semaglutide, Placebo + Placebo, cagrilintide semaglutide, cagrilintide semaglutide

Primary endpoint: Change in weekly average Pain Intensity-Numerical Rating Scale (PI-NRS)
Endpoint(s): Participants reaching ≥30 % reduction in PI-NRS Pain (yes/no), Time to achieve ≥30% reduction in weekly average PI-NRS Pain, Participants reaching ≥50 % reduction in PI-NRS Pain (yes/no), Time to achieve ≥50% reduction in weekly average PI-NRS Pain, Change in Brief Pain Inventory-Short Form (BPI-SF), Change in Chronic Pain Sleep Inventory 3-item (CPSI 3), Change in Michigan Neuropathy Screening Instrument (MNSI), Change in systolic blood pressure, Change in diastolic blood pressure, Change in glycated haemoglobin (HbA1c), Change in Fasting Plasma Glucose (FPG), Relative change in body weight, Change in waist circumference, Ratio to baseline in: Total cholesterol, High-density lipoprotein (HDL) cholesterol, Low-density lipoprotein (LDL) cholesterol, Very low-density lipoprotein (VLDL) cholesterol, Triglycerides, Free fatty acids, Non-HDL cholesterol, Relative change in high-sensitivity C-reactive protein (hsCRP), Number of treatment-emergent adverse events (TEAEs), Number of treatment-emergent serious adverse events (TESAEs), Number of severe hypoglycaemic episodes (level 3), Number of clinically significant hypoglycaemic episodes (level 2) (<3.0 mmol/L (54 mg/dL) confirmed by BG meter))

Source: https://euclinicaltrials.eu/ctis-public/view/2023-509662-38-00